EU clinical trial 2023-506092-10-00: BelieveIT-201: A Randomized, Phase 2, Open-label Trial of TransCon TLR7/8 Agonist in Combination with Pembrolizumab, TransCon TLR7/8 Agonist in Combination with TransCon IL-2 β/γ, or Pembrolizumab Monotherapy as Neoadjuvant Therapy in Participants with Stage III-IVA Resectable Locoregionally Advanced Head and Neck Squamous Cell Carcinoma (LA-HNSCC)
Protocol code: ASND0038
Sponsor: Ascendis Pharma Oncology Division A/S (Pharmaceutical company). Phase: Therapeutic exploratory (Phase II). Countries: Spain (ended), Hungary (ended), Poland (ended), Germany (ended), Italy (ended).
Therapeutic area(s): Diseases [C] - Neoplasms [C04]
Gender: Female, Male. Age: 18-64 years. Enrolment: 43.
Status: Ended. Start date (EU): 2024-03-11. End date (EU): 2025-03-28. End date: 2025-03-29. Decision date: 2024-02-07. Results received: Yes. Last updated: 2025-05-07.
Decision dates by country: ES: 2024-02-07, IT: 2024-02-08, DE: 2024-02-09, HU: 2024-02-08, PL: 2024-02-09

Condition(s): Stage III-IVA Resectable Locoregionall Advanced Head and Neck Squamous Cell Carcinoma (LA-HNSCC)
Product: TransCon IL-2 ß/ү, TransCon TLR7/8 Agonist, KEYTRUDA 25 mg/mL concentrate for solution for infusion

Primary endpoint: MPR as assessed by external independent pathology review (IPR) is defined as ≤10% invasive squamous cell carcinoma (SCC) within the resected primary tumor specimen and all sampled regional lymph nodes
Endpoint(s): Pathological complete response (pCR) as assessed by external IPR at the time of definitive surgery is defined as no residual invasive SCC within the resected primary tumor specimen and all sampled regional lymph nodes, pCR per local assessment for pathological review, MPR per local assessment for pathological review, EFS is defined as the time from the date of randomization to the date of first record of any of the following events: disease progression; local or distant recurrence as assessed with imaging or biopsy as indicated, or death due to any cause, OS is defined as the time from randomization to death due to any cause, Incidence and severity of adverse events (AEs) and serious adverse events (SAEs)

Source: https://euclinicaltrials.eu/ctis-public/view/2023-506092-10-00